EU clinical trial 2023-505959-45-00: The effect of oral Semaglutide on bone turnover in patients with T2D: a randomized placebo-controlled clinical trial (SOBER II)
Sponsor: Odense University Hospital (Hospital/Clinic/Other health care facility). Phase: Therapeutic exploratory (Phase II). Countries: Denmark (ongoing, recruiting).
Therapeutic area(s): Diseases [C] - Nutritional and Metabolic Diseases [C18]
Gender: Female, Male. Age: 18-64 years, 65+ years. Enrolment: 64.
Status: Ongoing, recruiting. Start date (EU): 2024-05-31. Decision date: 2023-09-07. Results received: No. Last updated: 2025-11-13.

Condition(s): Type 2 diabetes
Product: SEMAGLUTIDE, SEMAGLUTIDE, SEMAGLUTIDE, PLACEBO, Tetracycline 250 mg Tablets

Primary endpoint: Percentage change in bone formation marker procollagen type 1 N-terminal propeptide (P1NP) after 52 weeks.
Endpoint(s): Change in bone strength, assessed by microindentation, Change in bone formation rate, based on dynamic histomorphometry of bone tissue, Change in bone degradation markers Collagen I, cross-linked C-terminal telopeptide (CTX), Change in bone formation markers osteocalcin and bone alkaline phosphatase, Change in bone mineral density, assessed by DXA scan, Change in trabecular and cortical volumetric bone density and estimated strength (finite element analysis), assessed using second generation high resolution peripheral quantitative CT, Change in fat and lean tissue distribution, assessed by DXA, Change in BMI, Change in HbA1c, Change in physical activity, based on analysis of International Physical Activity Questionnaire Short Form (IPAQ-SF).

Source: https://euclinicaltrials.eu/ctis-public/view/2023-505959-45-00